EU clinical trial 2023-506434-69-00: FINESSE; Optimization of albuminuria lowering therapies to individual patients with CKD using FINErenone and SEmaglutide (FINESSE-CKD)
Protocol code: 17456
Sponsor: Universitair Medisch Centrum Groningen (Hospital/Clinic/Other health care facility). Phase: Therapeutic exploratory (Phase II). Countries: Netherlands (ongoing, recruitment ended), Italy (ongoing, recruitment ended), Denmark (ongoing, recruitment ended), Spain (ongoing, recruitment ended).
Therapeutic area(s): Diseases [C] - Nutritional and Metabolic Diseases [C18]
Gender: Female, Male. Age: 18-64 years, 65+ years. Enrolment: 36.
Status: Ongoing, recruitment ended. Start date (EU): 2025-02-11. Decision date: 2024-04-30. Results received: No. Last updated: 2024-08-28.
Decision dates by country: ES: 2024-04-30, IT: 2024-05-03, NL: 2024-05-02, DK: 2024-04-30

Condition(s): Chronic Kidney Disease
Product: Rybelsus 7 mg tablets, Kerendia 20 mg film-coated tablets, Rybelsus 3 mg tablets, Rybelsus 14 mg tablets

Primary endpoint: Endpoint parameter is the percentage change from baseline in UACR.
Endpoint(s): Percentage change from baseline in UACR., Number of missed urine collection in the remote (@home) setting

Source: https://euclinicaltrials.eu/ctis-public/view/2023-506434-69-00